EU clinical trial 2022-502244-12-00: (21140 ARANOTE) A randomized, double-blind, placebo-controlled Phase 3 study of darolutamide in addition to androgen deprivation therapy (ADT) versus placebo plus ADT in men with metastatic hormone-sensitive prostate cancer (mHSPC).
Protocol code: 21140
Sponsor: Bayer Consumer Care AG, Bayer AG (Pharmaceutical company). Phase: Therapeutic confirmatory (Phase III). Countries: Spain (ended), Latvia (ended), Lithuania (ended).
Therapeutic area(s): Diseases [C] - Congenital, Hereditary, and Neonatal Diseases and Abnormalities [C16]
Gender: Male. Age: 18-64 years, 65+ years. Enrolment: 132.
Status: Ended. Start date (EU): 2021-02-22. End date (EU): 2025-11-06. End date: 2026-01-23. Decision date: 2023-05-20. Results received: No. Last updated: 2025-12-01.
Decision dates by country: LV: 2023-05-20, LT: 2023-06-15, ES: 2023-05-22

Condition(s): Metastatic hormone-sensitive prostate cancer (mHSPC)
Product: BAY 1841788, Placebo of BAY 1841788

Primary endpoint: Radiological progression-free survival
Endpoint(s): Overall survival (OS), Time to castration–resistant prostate cancer (CRPC), Time to initiation of subsequent anti-cancer therapy, Time to PSA progression, Percentage of participants with detectable PSA values (≥0.2 ng/mL) at baseline which become undetectable (<0.2 ng/mL), Time to pain progression, Number of participants with treatment emergent adverse events

Source: https://euclinicaltrials.eu/ctis-public/view/2022-502244-12-00